EU clinical trial 2024-513469-38-00: A Window of Opportunity (WoO) study evaluating pembrolizumab with or without olaparib in Tertiary Lymphoid Structures (TLS)-positive selected resectable Soft Tissue Sarcoma (STS) followed by adjuvant pembrolizumab (NeoSarc)
Protocol code: 2023/3610 NEOSARC
Sponsor: Institut Gustave Roussy (Hospital/Clinic/Other health care facility). Phase: Therapeutic exploratory (Phase II). Countries: France (ended).
Therapeutic area(s): Diseases [C] - Neoplasms [C04]
Gender: Female, Male. Age: 18-64 years, 65+ years. Enrolment: 36.
Status: Ended. Start date (EU): 2024-12-10. End date (EU): 2025-08-13. Decision date: 2024-08-29. Results received: No. Last updated: 2025-06-30.

Condition(s): Undifferentiated pleomorphic sarcoma and Dedifferentiated liposarcoma
Product: Olaparib, KEYTRUDA 25 mg/mL concentrate for solution for infusion, Olaparib

Primary endpoint: The primary clinical evaluation criterion will be 50% increase in CD8+ T-cell tumor infiltration density between baseline biopsy and resection surgery specimen as defined by expert pathologist who will be blinded for treatment arm and patient outcome
Endpoint(s): Percentage of residual viable cells on the resection surgery specimen as assessed by expert pathologist after WoO treatment, Proportion of patients with 70% pathological response on the resection surgery specimen as assessed by expert pathologist after WoO treatment, Objective Response Rate (ORR) at 4 weeks of WoO treatment defined as the rate of patients with Complete Response (CR) or Partial Response (PR) according to RECIST v1.1Disease Control Rate (DCR) at 4 weeks of WoO according to RECIST v1.1, Maximum percentage of shrinkage from baseline in the sum of the reference diameters of the target lesions (selected according to RECIST), Local Recurrence Rate (LRR) at 2-year post-surgery, Time To Relapse (TTR), Disease Free Survival (DFS) at 2-year post-surgery, Overall Survival (OS), Quality of resection and amputation rate

Source: https://euclinicaltrials.eu/ctis-public/view/2024-513469-38-00